EU clinical trial 2024-516768-28-00: Open-label, Multicenter, Randomized Clinical Trial to Evaluate the Efficacy and Safety of Aripiprazole vs Paliperidone/Risperidone Using Multi-omics Data in Patients With a First Episode Psychosis
Protocol code: SchizOMICS
Sponsor: Consorcio Centro De Investigacion Biomedica En Red (Laboratory/Research/Testing facility). Phase: Therapeutic use (Phase IV). Countries: Spain (ongoing, recruiting).
Therapeutic area(s): Psychiatry and Psychology [F] - Mental Disorders [F03]
Gender: Female, Male. Age: 0-17 years, 18-64 years. Enrolment: 244.
Status: Ongoing, recruiting. Start date (EU): 2024-12-16. Decision date: 2024-12-16. Results received: No. Last updated: 2026-01-23.

Condition(s): Schizophrenia, Patients with a first psychotic episode, Treatment-resistant Schizophrenia
Product: Xeplion 150 mg and Xeplion 100 mg prolonged release suspension for injection, Abilify Maintena 960 mg prolonged-release suspension for injection in pre-filled syringe, BYANNLI 700 mg prolonged-release suspension for injection in pre-filled syringe, BYANNLI 1 000 mg prolonged-release suspension for injection in pre-filled syringe, TREVICTA 175 mg prolonged release suspension for injection, Abilify Maintena 300 mg powder and solvent for prolonged-release suspension for injection, OKEDI 100 mg powder and solvent for prolonged-release suspension for injection

Primary endpoint: Therapeutic response to aripiprazole or paliperidone
Endpoint(s): Change in positive psychotic symptoms at 3 and 12 months. Measured as change in PANSS positive symptom subscale score from baseline., Change in negative symptoms assessed with the PANSS at 3 and 12 months. Measured as change in PANSS negative symptom subscale score from baseline., Change in negative symptoms assessed with the SANS at 3 and 12 months. Measured as a change in the SANS scale score compared to baseline., Change in depressive symptoms at 3 and 12 months. Measured as change in CDS scale score from baseline., Change in functionality at 3 and 12 months. Measured as a change in the PSP scale score compared to baseline., Change in quality of life at 3 and 12 months. Measured as a change in the visual-analog scale of the EuroQoL scale with respect to baseline., Side effects at 3 and 12 months evaluated with the UKU scale. The total score (number of side effects) and qualitatively each side effect are assessed., Changes at 3 and 12 months in anthropometric measurements (weight, BMI, abdominal circumference), cardiovascular (blood pressure, heart rate) and laboratory tests (glycaemia, lipid profile, prolactin).

Source: https://euclinicaltrials.eu/ctis-public/view/2024-516768-28-00